EU clinical trial 2024-514528-17-00: MULTICENTER, RANDOMIZED, BLIND AND CONTROLLED CLINICAL TRIAL TO EVALUATE THE EFFICACY AND SAFETY OF XXXXXX IN THE CORRECTION OF 25(OH)D DEFICIT IN SUBJECTS WITH SEVERE VITAMIN D DEFICIENCY, COMPARED TO XXXXXX. DTREAT STUDY.
Protocol code: RES-6128-C1
Sponsor: Itf Research Pharma S.L. (Pharmaceutical company). Phase: Therapeutic use (Phase IV). Countries: Spain (ended).
Therapeutic area(s): Not possible to specify
Gender: Female, Male. Age: 18-64 years, 65+ years. Enrolment: 120.
Status: Ended. Start date (EU): 2025-09-15. End date (EU): 2026-07-09. Decision date: 2024-08-02. Results received: No. Last updated: 2026-02-24.

Condition(s): Severe vitamin D deficiency
Product: Deltius 50.000 UI cápsulas duras. Colecalciferol (Vitamina D3), CALCIFEDIOL

Primary endpoint: Percentage of patients achieving 25(OH)D levels ≥ 20 ng/ml after 6 weeks of treatment.
Endpoint(s): Percentage of patients achieving 25(OH)D levels ≥ 20 ng/ml after 12 (Phase I+II) weeks of treatment., Percentage of patients achieving different levels of 25(OH)D after 6 (Phase I) and 12 (Phase I+II) weeks of treatment based on post-treatment 25(OH)D values., Percentage of patients achieving different levels of 25(OH)D after 12 (Phase II) weeks of treatment, based on values of 25(OH)D after 6 weeks of treatment (Phase I)., Absolute and relative differences in 25(OH)D concentrations after 6 (Phase I) and 12 (Phase I+II) weeks of treatment compared to baseline values and after 12 (Phase II) weeks of treatment compared to the values of week 6., Plasma 25(OH)D curves: the variable of 25(OH)D concentration will be represented at the three time points measured: baseline visit, visit 2 (after 6 weeks of treatment, Phase I) and visit 3 (after 12 weeks of treatment, Phase II and after the maintenance phase, Phase IIb)., Absolute and relative differences in vitamin D metabolism parameters after 6 (Phase I) and 12 (Phase I+II) weeks of treatment compared to baseline and after 12 weeks (Phase II only) of treatment compared to values after 6 weeks of treatment., Absolute and relative differences and frequency of values outside the normal range of bone metabolism parameters after 6 (Phase I) and 12 weeks (Phase I+II) of treatment with respect to baseline values and after 12 weeks (Phase II only) of treatment with respect to values after 6 weeks of treatment., The degree of adherence will be calculated after 6 (Phase I) and 12 (Phase II) weeks of treatment during the study period., The degree of satisfaction with the treatment will be assessed by both the patient and the investigator independently at 6 (Phase I) and 12 (Phase II) weeks of treatment using a Likert-type question with 4 options: "How satisfied are you with the study medication?", possible answers: Very dissatisfied, dissatisfied, satisfied, and very satisfied., The degree of treatment recommendation perceived by the investigator will be evaluated after 12 weeks of treatment through a question with a 4-choice Likert answer: "What is the degree of recommendation of the study medication?", possible answers: very positive, positive, negative and very negative. The causes of such a response should also be described, having to select one or more of the following options: efficacy, safety, pharmacokinetic profile, available clinical evidence, ease of of admin, Calcium intake will be assessed at baseline by the absolute value of calcium consumed per day by the patient. This value will be estimated by the SEIOMM daily calcium intake calculator., The safety of treatment during the study will be assessed by the Incidence of Adverse Events and Serious Adverse Events over the entire study period.

Source: https://euclinicaltrials.eu/ctis-public/view/2024-514528-17-00